EU clinical trial 2024-511897-64-00: CA-CIBLE : Impact of increasing the ionized serum calcium target post-filter on the effectiveness of regional citrate anticoagulation during continuous extra-renal purification in intensive care: multicenter randomized controlled non-inferiority study.
Protocol code: APHP220257
Sponsor: Assistance Publique Hopitaux De Paris (Hospital/Clinic/Other health care facility). Phase: Phase III and phase IV (Integrated). Countries: France (ended).
Therapeutic area(s): Analytical, Diagnostic and Therapeutic Techniques and Equipment [E] - Therapeutics [E02]
Gender: Female, Male. Age: 18-64 years, 65+ years. Enrolment: 412.
Status: Ended. Start date (EU): 2023-07-01. End date (EU): 2024-12-31. Decision date: 2024-10-25. Results received: No. Last updated: 2024-10-25.

Condition(s): Adult patients hospitalized in intensive care with an indication of EER with ARC during the stay.
Product: Regiocit solution pour hémofiltration

Primary endpoint: The primary endpoint is the incidence of filter thrombosis (in %).
Endpoint(s): The lifespan of each hemofilter measured in hours. The cause of the cessation of the EER will be informed among 6 previously defined methods: • Filter thrombosis • Catheter dysfunction: inlet pressure too negative (less than -150mmHg) or outlet pressure too positive (greater than +150mmHg) • Transport: restitution for patient mobilization • Futility: no indication to continue the EER • End of session: EER for more than 72 hours • Other, Post-filter Ca2+ (in mmol/l) measured during the EER session, Citrate infusion rates (PPS) in mmol/l, The incidence of suspected citrate accumulation syndrome defined by a hypocalcemia associated with a total calcium/ionized calcium ratio greater than 2.5, The occurrence of the following 5 metabolic complications: • Hypocalcemia [Ca2+ < 0.95mmol/l] • Metabolic acidosis [PH < 7.3 and HCO3- < 20mmol/l] • Metabolic alkalosis [PH > 7.5 and HCO3- > 30mmol/l] • Hypernatraemia [Na+ > 145mmol/l] • Hypomagnesemia [Mg2+ < 0.70mmol/l], The costs (in euros) induced by each hemofilter change and the quantities citrate infused, The impossibility of restoring the EER circuit at the end of the EER session (equivalent 200mL of blood)

Source: https://euclinicaltrials.eu/ctis-public/view/2024-511897-64-00